EU clinical trial 2025-521666-10-01: PirtobrUtinib as frontline Therapy for elderly unfit/frail patient with MAntle cell lymphoma: a phase II study of the Fondazione Italiana Linfomi (FIL)
Protocol code: FIL_PUMA
Sponsor: Fondazione Italiana Linfomi Ets (Patient organisation/association). Phase: Therapeutic exploratory (Phase II). Countries: Italy (ongoing, recruiting).
Therapeutic area(s): Diseases [C] - Hemic and Lymphatic Diseases [C15]
Gender: Female, Male. Age: 65+ years. Enrolment: 56.
Status: Ongoing, recruiting. Start date (EU): 2026-06-08. Decision date: 2026-02-26. Results received: No. Last updated: 2026-04-30.

Condition(s): Mantle Cell Lymphoma
Product: PIRTOBRUTINIB

Primary endpoint: PFS defined as the time between the start of treatment and the first documentation of recurrence, progression or death for any cause
Endpoint(s): Overall response rate [ORR = complete response (CR) + partial response (PR) rate) (according to Lugano, 2014 criteria)], Complete response rate (CRR), Overall survival (OS) defined as the time between the start of treatment and death from any cause, Event free survival (EFS) defined as the time between the start of treatment and treatment failure including disease progression, or discontinuation of treatment for any reason (e.g., disease progression, toxicity, patient preference, initiation of new treatment without documented progression, or death), Duration of response (DOR) defined as the time from the first documentation of tumor response to disease progression or death from any cause, Drop-out rate, Rate of treatment discontinuation due to AE or treatment intolerance, Frequency and severity of AEs and SAEs classified as per latest version of CTCAE, The health-related quality of life (HRQoL) as measured by the EuroQol 5-Dimension Scale (EQ-5D-5L) and the Functional Assessment of Cancer Therapy for Patients with Lymphoma (FACTLym) standardized questionnaire on health status

Source: https://euclinicaltrials.eu/ctis-public/view/2025-521666-10-01